EU clinical trial 2022-501822-39-00: A study to evaluate the safety and efficacy of the tumor-targeting human antibody-cytokine fusion protein L19TNF plus lomustine in patients with glioblastoma at first progression
Protocol code: PH-L19TNFCCNU-02-20
Sponsor: Philogen S.p.A. (Pharmaceutical company). Phase: Phase I and Phase II (Integrated)- Other. Countries: Germany (ongoing, recruitment ended), Italy (ongoing, recruitment ended), France (ongoing, recruitment ended).
Therapeutic area(s): Diseases [C] - Neoplasms [C04]
Gender: Female, Male. Age: 18-64 years, 65+ years. Enrolment: 113.
Status: Ongoing, recruitment ended. Start date (EU): 2023-07-31. Decision date: 2023-02-15. Results received: No. Last updated: 2025-12-22.
Decision dates by country: IT: 2023-02-16, FR: 2023-02-16, DE: 2023-02-15

Condition(s): Glioblastoma

Source: https://euclinicaltrials.eu/ctis-public/view/2022-501822-39-00